EU clinical trial 2022-501794-39-00: A PHASE III, MULTICENTER, RANDOMIZED, DOUBLE MASKED, SHAM-CONTROLLED STUDY TO INVESTIGATE THE EFFICACY, SAFETY, PHARMACOKINETICS, AND PHARMACODYNAMICS OF RO7200220 ADMINISTERED INTRAVITREALLY IN PATIENTS WITH UVEITIC MACULAR EDEMA
Protocol code: GR44278
Sponsor: F. Hoffmann-La Roche AG (Pharmaceutical company). Phase: Therapeutic confirmatory (Phase III). Countries: Spain (ended), Germany (ended), Czechia (ended), France (ended), Italy (ended), Portugal (ended), Poland (not authorised).
Therapeutic area(s): Diseases [C] - Eye Diseases [C11]
Gender: Female, Male. Age: 18-64 years, 65+ years. Enrolment: 70.
Status: Ended. Start date (EU): 2023-06-28. End date (EU): 2025-11-27. End date: 2025-12-24. Decision date: 2023-04-20. Results received: No. Last updated: 2025-10-16.
Decision dates by country: CZ: 2023-04-21, FR: 2023-04-20, IT: 2024-09-27, PT: 2024-09-24, DE: 2023-04-20, ES: 2023-04-24

Condition(s): Uveitic Macular Edema
Product: IL6-Mab, IL6-Mab

Primary endpoint: Proportion of participants with ≥15 letter improvement from baseline in BCVA at Week 16
Endpoint(s): Proportion of participants with ≥15 letter improvement from baseline in BCVA at Week 20 (8 weeks after the final fixed-interval study drug dose at week 12), Change from baseline in BCVA score at Week 16, Change from baseline in central subfield thickness (CST) at Week 16, Change from baseline in BCVA at Weeks 20 and 52, Change from baseline in CST at Weeks 20 and 52, Proportion of participants with UME resolution from baseline at Weeks 16 and 52, Time to rescue treatment and number and type of rescue treatments received, Proportion of participants with ≥15 letter improvement from baseline in BCVA at Week 52, Proportion of participants without ≥15 letter loss from baseline in BCVA at Weeks 16 and 52 French 9. Proportion de participants sans, Number of pro re nata (PRN) injections received, Time to first PRN injection, Change from baseline in the National Eye Institute Visual Function Questionnaire‑25 NEI VFQ‑25 composite score at Weeks 16 and 52, Incidence and severity of ocular adverse events, non-ocular adverse events, adverse events of special interest and selected adverse events, Percent change from baseline in corneal endothelial cell density at Weeks 24 and 52, AH concentration of RO7200220 (pharmacokinetics) over time, Serum concentration of RO7200220 (pharmacokinetics) over time, IL‑6 suppression in AH, Incidence and titer of ADAs to RO7200220 during the study relative to the prevalence of ADAs at baseline, Relationship between ADA status and efficacy, safety, ocular PK, PD endpoints

Source: https://euclinicaltrials.eu/ctis-public/view/2022-501794-39-00